EU clinical trial 2024-513464-26-00: A randomized phase III trial assessing the benefit of the addition of isatuximab to lenalidomide / bortezomib / dexamethasone (RVd) induction and lenalidomide maintenance in patients with newly diagnosed multiple myeloma (GMMG-HD7)
Protocol code: GMMG-HD7
Sponsor: Universitaetsklinikum Heidelberg AöR (Hospital/Clinic/Other health care facility). Phase: Therapeutic confirmatory (Phase III). Countries: Germany (ongoing, recruitment ended).
Therapeutic area(s): Diseases [C] - Hemic and Lymphatic Diseases [C15]
Gender: Female, Male. Age: 18-64 years, 65+ years. Enrolment: 662.
Status: Ongoing, recruitment ended. Start date (EU): 2018-10-18. Decision date: 2024-07-31. Results received: No. Last updated: 2026-04-24.

Condition(s): Multiple Myeloma
Product: Lenalidomide, Lenalidomide, Isatuximab, Lenalidomide, VELCADE 3.5 mg powder for solution for injection, Lenalidomide, DEXAMETHASONE

Primary endpoint: The study will investigate two primary endpoints:(1) minimal residual disease (MRD) negativity after induction (assessed by flow cytometry; sensitivity 1e-5), defined as proportion of patients with negative MRD after induction., (2) progression-free survival (PFS), defined as time from 2nd randomization (prior to maintenance) to progression or death from any cause whichever occurs first.
Endpoint(s): Key Secondary Endpoint: PFS, defined as time from 1st randomization (at study inclusion) to progression or death from any cause whichever occurs first., OS defined as time from 1st randomization and from 2nd randomization to time of death from any cause. Patients still being alive at the time of the analysis will be censored at the date last known to be alive., Complete response (CR) rates. The analysis will be based on the CR rate which is the proportion of patients achieving complete response (CR) to treatment adjusted after removal of isatuximab interference in the immunofixation test in the relevant patient subpopulations., MRD negativity after high dose therapy, during and after 3 years of maintenance treatment (flow cytometry) defined as the proportion of patients with negative MRD after high dose therapy, during and after 3 years of maintenance treatment (flow cytometry), respectively., Sustained MRD-negativity, defined as the maintenance of MRD-negativity (assessed by NGF at a sensitivity of 10-5) >=6 / >=12 months apart (after first occurrence of MRD negativity), best response to treatment during the trial (adjusted after removal of isatuximab interference in the immunofixation test in the relevant patient subpopulations)., PFS 2 (PFS after next line of therapy) from 2nd randomization, quality of life

Source: https://euclinicaltrials.eu/ctis-public/view/2024-513464-26-00